EU clinical trial 2024-515369-33-00: PHASE 1B/II TRIAL OF CHECKPOINT INHIBITOR (PEMBROLIZUMAB AND ANTI PD-1 ANTIBODY) PLUS STANDARD IMRT IN HPV INDUCED STAGE III SQUAMOUS CELL CARCINOMA OF ANUS
Sponsor: Cardiff University (Educational Institution). Phase: Phase I and Phase II (Integrated)- Bioequivalence Study. Countries: Norway (authorised, recruitment pending).
Therapeutic area(s): Diseases [C] - Neoplasms [C04]
Gender: Female, Male. Age: 18-64 years, 65+ years. Enrolment: 3.
Status: Authorised, recruitment pending. Decision date: 2025-01-14. Results received: No. Last updated: 2025-01-14.

Condition(s): Anal cancer
Product: KEYTRUDA 25 mg/mL concentrate for solution for infusion

Primary endpoint: Safety and tolerability of a combination of two different schedules of exposure to pembrolizumab concomitantly with standard CRT in patients with locally advanced anal cancer by assessing AEs / SAEs and extent of protocol adherence by trial population
Endpoint(s): Feasibility of combining pembrolizumab with standard CRT in two different schedules in patients with locally advanced anal cancer as measured by: Adherence to protocol treatment, as assessed by numbers of patients receiving per protocol treatment, dose delays, treatment reductions, treatment discontinuation and documenting the reasons for delays or discontinuation for each patient., Retention as assessed by the proportion of patients withdrawing from protocol treatment and number of patients lost to follow-up with documentation of reasons in each case., Recruitment rate as assessed by the number of days trial is open for recruitment, the number of patients screened, the number of screened patients not recruited and why and the number (proportion) of patients recruited., Trial eligibility as assessed by the number of patients eligible and ineligible at screening and reasons for ineligibility., Clinical response assessment for the overall response rate (ORR) at 12 weeks post-CRT and at 6 months post-CRT and 12 months follow up., Imaging response assessments by TRG MRI by changes in Apparent Diffusion Coefficient (ADC) on DW sequences. Immune related modified RECIST assessments (MRI) at 3 and 6 months post-CRT and at 12 months follow up., Patient-reported outcomes (PRO) using the EORTC tool during CRT, pembrolizumab monotherapy and 6 months post-CRT and 12 months follow-up to assess symptomatic toxicity both acute and late.

Source: https://euclinicaltrials.eu/ctis-public/view/2024-515369-33-00